EU clinical trial 2023-503844-14-00: A Study of EOS301984 in Adult Participants with Advanced Solid Tumors
Protocol code: APT-008
Sponsor: iTeos Belgium (Pharmaceutical company). Phase: Human Pharmacology (Phase I)- First administration to humans. Countries: Belgium (ongoing, recruitment ended).
Therapeutic area(s): Diseases [C] - Neoplasms [C04]
Gender: Female, Male. Age: 18-64 years, 65+ years. Enrolment: 84.
Status: Ongoing, recruitment ended. Start date (EU): 2023-06-13. Decision date: 2023-05-08. Results received: No. Last updated: 2025-12-26.

Condition(s): Advanced Solid Tumors

Source: https://euclinicaltrials.eu/ctis-public/view/2023-503844-14-00